EU clinical trial 2024-512230-15-00: GALOP: Oral Glibenclamide in premature hyperglycemia
Protocol code: P160916J
Sponsor: Assistance Publique Hopitaux De Paris (Hospital/Clinic/Other health care facility). Phase: Therapeutic exploratory (Phase II). Countries: France (ended).
Therapeutic area(s): Diseases [C] - Nutritional and Metabolic Diseases [C18]
Gender: Female, Male. Age: 0-17 years. Enrolment: 35.
Status: Ended. Start date (EU): 2023-05-20. End date (EU): 2026-01-08. Decision date: 2024-06-24. Results received: No. Last updated: 2025-12-18.

Condition(s): Transient hyperglycaemia in premature infants
Product: AMGLIDIA 6 mg/mL oral suspension

Primary endpoint: The primary outcome is 72 hours glycaemic control on glibenclamide treatment (success of the treatment). This is defined as the non-use of insulin and absence of severe hypoglycaemia (< 1.5 mmol/l) or persistent moderate hypoglycaemia (< 2.6 mmol/l in 2 successive capillary measurements at an interval of more than 3 hours)
Endpoint(s): • Overall success of the treatment defined by continuation to the end of treatment without insulin use., • Glycaemic profile under glibenclamide (see protocol), • Duration of glibenclamide treatment., • Nutritional intakes and growth (see protocol), • Number of children with at least one episode of moderate (blood glucose < 2.6 mmol/l) or severe (< 1.5 mmol/l) hypoglycaemia within the first 72 hours of treatment and for the duration of treatment, • Number and type of adverse reactions to glibenclamide (see protocol), • Neonatal morbidity assessed at 36 weeks post-menstrual age: intraventricular haemorrhage, periventricular leukomalacia, retinopathy of premature newborns, haemodynamic disorders, necrotising enterocolitis, • Mortality at 36 weeks post-menstrual age, • Number of dose adjustments, • Ease of use assessment score by caregivers, • Plasma concentrations of glibenclamide

Source: https://euclinicaltrials.eu/ctis-public/view/2024-512230-15-00